EU clinical trial 2023-503652-27-00: A Phase 3, Randomized, Double-blind, Placebo- and Active-Comparator-Controlled Clinical study of Adjuvant V940 (mRNA-4157) Plus Pembrolizumab Versus Adjuvant Placebo Plus Pembrolizumab in Participants with High-risk Stage II-IV Melanoma (INTerpath-001)
Protocol code: V940-001
Sponsor: Merck Sharp & Dohme LLC (Pharmaceutical company). Phase: Therapeutic confirmatory (Phase III). Countries: Germany (ongoing, recruitment ended), France (ongoing, recruitment ended), Italy (ongoing, recruitment ended), Belgium (ongoing, recruitment ended), Poland (ongoing, recruitment ended), Denmark (ongoing, recruitment ended), Sweden (ongoing, recruitment ended), Spain (ongoing, recruitment ended), Portugal (ongoing, recruitment ended), Greece (ongoing, recruitment ended).
Therapeutic area(s): Diseases [C] - Neoplasms [C04]
Gender: Female, Male. Age: 18-64 years, 65+ years. Enrolment: 625.
Status: Ongoing, recruitment ended. Start date (EU): 2023-10-06. Decision date: 2023-09-18. Results received: No. Last updated: 2026-06-26.
Decision dates by country: ES: 2023-09-25, GR: 2023-09-21, SE: 2023-09-20, FR: 2023-09-21, IT: 2023-09-22, DK: 2023-09-18, PL: 2023-09-25, BE: 2023-09-20, PT: 2023-09-19, DE: 2023-09-25

Condition(s): Melanoma
Product: Placebo to V940 (mRNA-4157), mRNA-4157, KEYTRUDA 25 mg/mL concentrate for solution for infusion

Primary endpoint: Recurrence-Free Survival (RFS)
Endpoint(s): Distant Metastasis Free Survival (DMFS), Overall Survival, Number of Participants Experiencing Adverse Events (AEs), Number of Participants Discontinuing Study Treatment Due to AEs, Change in Score from Baseline Evaluated by: - Global Health Status/Quality of Life (QoL) score (QLQ-C30 Items 29 and 30), Change in Score from Baseline Evaluated by: - Physical Functioning Score (QLQ-C30 Items 1 to 5), Change in Score from Baseline Evaluated by: - Role Functioning Score (QLQ-C30 Items 6 and 7)

Source: https://euclinicaltrials.eu/ctis-public/view/2023-503652-27-00